EU clinical trial 2023-509762-38-00: A phase 3b, randomized, open label, multi-country, multi-center, extension and crossover vaccination study to evaluate the immunogenicity and safety of different revaccination schedules and persistence of a single dose of the RSVPreF3 OA vaccine in adults aged 60 years and above who participated in the RSV OA=ADJ-006 study
Protocol code: 222090
Sponsor: GlaxoSmithKline Biologicals (Pharmaceutical company). Phase: Therapeutic confirmatory (Phase III). Countries: Germany (ongoing, recruitment ended), Finland (ongoing, recruitment ended), Estonia (ongoing, recruitment ended), Belgium (ongoing, recruitment ended), Poland (ongoing, recruitment ended), Spain (ongoing, recruitment ended), Italy (ongoing, recruitment ended).
Therapeutic area(s): Diseases [C] - Respiratory Tract Diseases [C08]; Diseases [C] - Virus Diseases [C02]
Gender: Female, Male. Age: 18-64 years, 65+ years. Enrolment: 4918.
Status: Ongoing, recruitment ended. Start date (EU): 2024-08-01. Decision date: 2024-06-06. Results received: No. Last updated: 2026-06-19.
Decision dates by country: BE: 2024-06-10, EE: 2024-06-14, FI: 2024-06-07, IT: 2024-06-11, DE: 2024-06-06, PL: 2024-06-14, ES: 2024-06-10

Condition(s): Respiratory Syncytial Virus Infections
Product: Arexvy powder and suspension for suspension for injection Respiratory Syncytial Virus (RSV) vaccine (recombinant, adjuvanted)

Primary endpoint: RSV_PreS4 group: - RSV-A and RSV-B neutralizing titers before revaccination (pre-Season 4, Day 1) and 30 days post-revaccination (Day 31) - Fold increase in RSV-A and RSV-B neutralizing titers from Day 1 to Day 31 - RSV-A and RSV-B neutralizing titers ≥cut-off at Day 1 and Day 31 - Participant having a ≥4-fold increase in neutralizing titers (Day 31 over Day 1), "RSV_PreS5 group: - RSV-A and RSV-B neutralizing titers before revaccination (pre-Season 4 and pre-Season 5), 30 days post-revaccination and at pre-Season 6 - Fold increase in RSV-A and RSV-B neutralizing titers from pre-Season 5 to Day 31 and pre-Season 6 - RSV-A and RSV-B neutralizing titers ≥cut-off at pre-Season 4, pre-Season 5, Day 31 and pre-Season 6 - Participant having a ≥4-fold increase in neutralizing titers (Day 31 over pre-Season 5)"
Endpoint(s): "RSV_1dose group: - RSV-A and RSV-B Neutralizing titers at pre-Season 4, pre-Season 5 and pre-Season 6 - RSV-A and RSV-B Neutralizing titers ≥cut-off at pre-Season 4, pre-Season 5 and pre-Season 6 ", "All participants: - Occurrence of unsolicited AEs with an onset during the 30-day follow-up period after vaccination (i.e., the day of vaccination and 29 subsequent days) - Occurrence of all SAEs/pIMDs from the day of vaccination up to 6 months after vaccination - Occurrence of SAEs/pIMDs related to study vaccination from Day 1 up to study end - Occurrence of fatal SAEs from Day 1 up to study end"

Source: https://euclinicaltrials.eu/ctis-public/view/2023-509762-38-00